EU clinical trial 2025-523885-25-00: A Single-Center, Double-Blind, Randomized, Placebo Controlled Phase 1 Study to Investigate the Safety, Tolerability, Pharmacokinetics, and Pharmacodynamics of Single- and Multiple-Ascending Doses of ACI-19764 in Healthy Participants and in Participants with Cardiovascular Risk Factors
Protocol code: ACI-19764-2501
Sponsor: AC Immune S.A. (Pharmaceutical company). Phase: Human Pharmacology (Phase I)- First administration to humans. Countries: Netherlands (ongoing, recruiting).
Therapeutic area(s): Diseases [C] - Nutritional and Metabolic Diseases [C18]; Diseases [C] - Nervous System Diseases [C10]
Gender: Female, Male. Age: 18-64 years, 65+ years. Enrolment: 114.
Status: Ongoing, recruiting. Start date (EU): 2026-01-21. Decision date: 2026-01-13. Results received: No. Last updated: 2026-06-26.

Condition(s): Healthy Volunteers, Participants with diabetes and/or obesity

Source: https://euclinicaltrials.eu/ctis-public/view/2025-523885-25-00